EU clinical trial 2022-502013-28-00: STRAtified Dosing based on Augmented renal clearance for CEFtriaxone in patients with severe community-acquired pneumonia: the STRADA-CEF trial
Sponsor: UZ Leuven (Hospital/Clinic/Other health care facility). Phase: Therapeutic use (Phase IV). Countries: Belgium (ongoing, recruiting).
Therapeutic area(s): Diseases [C] - Bacterial Infections and Mycoses [C01]
Gender: Female, Male. Age: 18-64 years, 65+ years. Enrolment: 270.
Status: Ongoing, recruiting. Start date (EU): 2024-03-18. Decision date: 2023-12-11. Results received: No. Last updated: 2025-11-12.

Condition(s): Severe Community-Acquired Pneumonia
Product: CEFTRIAXONE

Primary endpoint: Intensive care unit (ICU) Length of Stay (LOS)
Endpoint(s): Delta SOFA score, ICU mortality, 28-day mortality, Hospital LOS, Alive ICU free days at day 28, Ventilator-free days at day 28, Clinical cure at day 14, Microbial eradication at day 14, Emergence of resistance at day 14, PK/PD target attainment, Assessment of safety, Procalcitonin and C-reactive protein concentrations

Source: https://euclinicaltrials.eu/ctis-public/view/2022-502013-28-00